EU clinical trial 2023-505009-17-00: A Phase III Double-blind Randomised Study Assessing the Efficacy and Safety of Capivasertib + Paclitaxel Versus Placebo + Paclitaxel as First-line Treatment for Patients with Histologically Confirmed, Locally Advanced (Inoperable) or Metastatic Triple-Negative Breast Cancer (TNBC) (CAPItello-290)
Protocol code: D3614C00001
Sponsor: AstraZeneca AB (Pharmaceutical company). Phase: Therapeutic confirmatory (Phase III). Countries: Spain (ended).
Therapeutic area(s): Diseases [C] - Neoplasms [C04]
Gender: Female, Male. Age: 18-64 years, 65+ years. Enrolment: 267.
Status: Ended. Start date (EU): 2019-06-21. End date (EU): 2025-04-22. Decision date: 2024-07-03. Results received: No. Last updated: 2025-05-05.

Condition(s): Triple-negative Breast Cancer
Product: Placebo for Capivasertib, PACLITAXEL, Capivasertib, Capivasertib

Primary endpoint: Overall Survival
Endpoint(s): Investigator assessment of PFS, Investigator assessment of PFS2, 3a Response Rate (ORR) - percentage of patients with at least one investigator-assessed visit response of complete or partial response (as assessed by the investigator, using RECIST 1.1)., 3b Duration of Response (DoR) - time from the date of first documented response until date of documented progression (as assessed by the investigator, using RECIST 1.1) or death in the absence of disease progression, 3c Clinical Benefit Rate (CBR) - number of patients with complete or partial response or with stable disease maintained ≥24 weeks (as assessed by the investigator, using RECIST 1.1) divided by the number of patients in the analysis., AEs/SAEs; vital signs; collection of clinical chemistry, haematology, glucose metabolism parameters; ECGs parameters., Plasma PK parameters derived from a population PK model of plasma concentrations and patient factors, EORTC QLQ BR23 (EORTC Quality of Life Questionnaire breast cancer specific module) and EORTC QLQ C30 (EORTC Quality of Life Questionnaire Core 30 items) scale/item scores

Source: https://euclinicaltrials.eu/ctis-public/view/2023-505009-17-00